EU clinical trial 2024-513334-38-00: A phase I safety, dose finding and feasibility trial of MB-CART19.1 in patients with relapsed or refractory CD19 positive B cell malignancies
Protocol code: M-2017-322
Sponsor: Miltenyi Biomedicine GmbH (Pharmaceutical company). Phase: Human Pharmacology (Phase I)- First administration to humans. Countries: Germany (ongoing, recruitment ended).
Therapeutic area(s): Diseases [C] - Hemic and Lymphatic Diseases [C15]; Diseases [C] - Neoplasms [C04]
Gender: Female, Male. Age: 0-17 years, 18-64 years, 65+ years. Enrolment: 49.
Status: Ongoing, recruitment ended. Start date (EU): 2018-05-15. Decision date: 2024-09-17. Results received: No. Last updated: 2025-07-17.

Condition(s): Refractory/relapsed B-NHL, Relapsed or refractory CD19 positive B cell malignancies (pediatric acute lymphatic leukemia [ALL], aggressive NHL), Relapsed or refractory CD19 positive B cell malignancies (adult ALL, adult NHL/chronic lymphatic leukemia [CLL])
Product: MB-CART19.1

Primary endpoint: Recommended dose of MB-CART19.1, determined on the basis of the maximum tolerated dose (MTD), defined as the highest dose level of the two to three dose levels tested at which <33% of patients experience DLT until day 28 after infusion of MB-CART19.1, and on the basis of the safety and efficacy data., Safety and toxicity assessment of MB-CART19.1 per adverse events (AE) reporting classified according to CTCAE version 5.0. defined by <33% of patients experiencing DLT, or maximal administered dose.
Endpoint(s): Overall incidence and severity of adverse events, Response to treatment: o Overall response rate (ORR) in ALL patients defined as the rate of complete remission (CR, CRh) on day 28; o Rate of ALL patients achieving MRD response (<10-4); o ORR in NHL patients is defined as the rate of overall response (CR or PR) on day 28 and at month 3 in patients not in CR on day 28, Occurrence of B cell depletion, Phenotype and persistence of MB-CART19.1, Further safety assessments., Proportion of patients meeting the inclusion criteria and none of the exclusion criteria for who an autologous MB-CART19.1 product can be generated;, Rate of ALL patients achieving MRD response (<10-4), Duration of response, relapse rate and time to relapse;, Disease-free and overall survival at 1 year after adoptive immunotherapy with MB-CART19.1 in patients not receiving alloSCT;

Source: https://euclinicaltrials.eu/ctis-public/view/2024-513334-38-00